EU clinical trial 2023-510227-30-00: Phase II Randomized Clinical Trial of quinacrine versus metronidazole in resistant giardiasis in children: Quin4Kids
Protocol code: QUIN4KIDS
Sponsor: Fundacion Para La Investigacion Biomedica Del Hospital Universitario La Paz (Patient organisation/association). Phase: Phase I and Phase II (Integrated)- Other. Countries: Spain (authorised, recruitment pending).
Therapeutic area(s): Diseases [C] - Parasitic Diseases [C03]
Gender: Female, Male. Age: 0-17 years. Enrolment: 48.
Status: Authorised, recruitment pending. Decision date: 2024-06-05. Results received: No. Last updated: 2026-03-17.

Condition(s): Intestinal giardiasis
Product: MEPACRINE 25 MG CAPSULES, MEPACRINE 5 MG CAPSULES, MEPACRINE 100 MG, Metronidazol NORMON 250 mg comprimidos EFG

Primary endpoint: Proportion of participants achieving microbiological eradication of Giardia intestinalis in each study arm.
Endpoint(s): Plasma drug concentration at the different time-points (Pharmacokinetic data)., Hair drug concentration at the different time-points (Pharmacokinetic data)., Proportion of patients with any adverse event., Proportion of drug discontinuation due to adverse effects. Tolerability., Proportion of strains carrying gene mutations related with metronidazole resistance., Proportion of co-parasitation., To generate pharmacokinetic data for the development of a specific pediatric galenic formulation., To obtain a cohort of resistant giardia isolates for further genetic characterization and/or cluster study., To characterize the cohort of pediatric patients harbouring resistant strains.

Source: https://euclinicaltrials.eu/ctis-public/view/2023-510227-30-00